EU clinical trial 2026-526168-19-00: Phase I Safety and Immunogenicity Study of a Multivalent Gonorrhoea Vaccine
Protocol code: LTBNG601
Sponsor: LimmaTech Biologics AG (Pharmaceutical company). Phase: Human Pharmacology (Phase I)- First administration to humans. Countries: Germany (ongoing, recruiting).
Therapeutic area(s): Diseases [C] - Bacterial Infections and Mycoses [C01]
Gender: Female, Male. Age: 18-64 years. Enrolment: 142.
Status: Ongoing, recruiting. Start date (EU): 2026-07-30. Decision date: 2026-07-07. Results received: No. Last updated: 2026-07-31.

Condition(s): Gonorrhea

Source: https://euclinicaltrials.eu/ctis-public/view/2026-526168-19-00